EU clinical trial 2025-521394-13-00: A Phase 1 Study of AUTX-703 in Participants with Relapsed/Refractory Acute Myeloid Leukemia and Myelodysplastic Syndromes
Protocol code: AUTX-703-001
Sponsor: Auron Therapeutics Inc. (Pharmaceutical company). Phase: Human Pharmacology (Phase I)- First administration to humans. Countries: France (authorised, recruitment pending).
Therapeutic area(s): Diseases [C] - Neoplasms [C04]
Gender: Female, Male. Age: 18-64 years, 65+ years. Enrolment: 10.
Status: Authorised, recruitment pending. Decision date: 2026-02-04. Results received: No. Last updated: 2026-02-04.

Condition(s): Relapsed/refractory Acute Myeloid Leukemia or relapsed/refractory myelodysplastic syndromes

Source: https://euclinicaltrials.eu/ctis-public/view/2025-521394-13-00